EU clinical trial 2024-511780-28-00: Window-of-opportunity proof-of-concept, non-randomized, open-label phase II trial of Olaparib given alone (cohort A) or in combination with Durvalumab (cohort B) prior to primary debulking surgery in histologically proven high-grade epithelial ovarian cancer (EOC)
Protocol code: AGO-OVAR 27
Sponsor: AGO Research GmbH (Pharmaceutical company). Phase: Therapeutic exploratory (Phase II). Countries: Germany (ongoing, recruiting).
Therapeutic area(s): Not possible to specify
Gender: Female. Age: 18-64 years, 65+ years. Enrolment: 60.
Status: Ongoing, recruiting. Start date (EU): 2022-05-05. Decision date: 2024-03-20. Results received: No. Last updated: 2026-06-19.

Condition(s): Patients with presumed and previously untreated advanced stage ovarian cancer planned to undergo laparoscopy for histologic diagnosis and treatment planning.
Product: Lynparza 100 mg film-coated tablets, Lynparza 150 mg film-coated tablets, IMFINZI 50 mg/mL concentrate for solution for infusion., Lynparza 150 mg film-coated tablets, Lynparza 100 mg film-coated tablets, IMFINZI 50 mg/mL concentrate for solution for infusion., Lynparza 150 mg film-coated tablets, Lynparza 150 mg film-coated tablets, Lynparza 150 mg film-coated tablets, Lynparza 100 mg film-coated tablets, Lynparza 150 mg film-coated tablets, Lynparza 100 mg film-coated tablets, IMFINZI 50 mg/mL concentrate for solution for infusion., IMFINZI 50 mg/mL concentrate for solution for infusion., IMFINZI 50 mg/mL concentrate for solution for infusion., Lynparza 100 mg film-coated tablets, IMFINZI 50 mg/mL concentrate for solution for infusion., IMFINZI 50 mg/mL concentrate for solution for infusion., IMFINZI 50 mg/mL concentrate for solution for infusion., Lynparza 100 mg film-coated tablets, Lynparza 150 mg film-coated tablets, Lynparza 100 mg film-coated tablets, Lynparza 150 mg film-coated tablets, Lynparza 100 mg film-coated tablets

Primary endpoint: Feasibility of WoO procedure defined as the successful completion of the WoO therapy: Relative dose intensity (RDI) of ≥80%. No treatment-related surgical delays. Adherence to therapeutic strategy. Lack of clinical progression prior to primary debulking surgery. No treatment-related toxicities of any grade that in the judgment of the investigator or surgeon significantly interfered with the subject’s optimal perioperative management
Endpoint(s): Safety of the WoO procedure. Evaluated by the proportion of patients who experience any adverse event (CTCAE v5.0), of a grade ≥3., Proportion of ctDNA mutation positive patients at baseline above a predefined a cut-off (copies/ml)., Circulating DNA ratio at day 21 (CDR21) defined as the ratio of mutation abundance at day 21 relative to baseline of the mutant ctDNA allele with the highest abundance (mutant copies/ml) at baseline., Progression free survival (PFS). Defined as the time from registration into the trial (PIC2) until progression defined as progressive disease according to RECIST or GCIG criteria or death without progression or clinical deterioration of performance status with associated signs of disease (e.g. bowel obstruction and non-measurable disease).

Source: https://euclinicaltrials.eu/ctis-public/view/2024-511780-28-00